EU clinical trial 2024-516250-22-00: Phase 2 study of belantamab mafodotin in combination with bortezomib and dexamethasone in patients with relapsed/refractory multiple myeloma
Protocol code: CMG012022
Sponsor: Ceska Myelomova Skupina z.s. (Patient organisation/association). Phase: Therapeutic exploratory (Phase II). Countries: Czechia (ongoing, recruitment ended).
Therapeutic area(s): Diseases [C] - Neoplasms [C04]
Gender: Female, Male. Age: 18-64 years, 65+ years. Enrolment: 40.
Status: Ongoing, recruitment ended. Start date (EU): 2023-04-17. Decision date: 2024-09-20. Results received: No. Last updated: 2026-06-04.

Condition(s): The study will enroll adult participants with RRMM who have been previously treated with at least 1 prior line of therapy, and who have documented disease progression during, or after, their most recent therapy.
Product: DEXAMETHASONE, BORTEZOMIB

Primary endpoint: 1. ORR, defined as the percentage of participants with a Partial Response (PR) or better (i.e., PR, Very Good Partial Response (VGPR), Complete Response (CR)) 2. Incidence rate of Grade ≥3 ocular adverse events according to the keratopathy visual acuity (KVA) scale

Source: https://euclinicaltrials.eu/ctis-public/view/2024-516250-22-00